EU clinical trial 2025-523133-26-00: The effect of anifrolumab on cutaneous lupus erythematosus characterized by the change of the inflammatory infiltrate analyzed by immunohistochemistry, spatial transcriptomics and single-cell RNA- and TCR-sequencing as well as on the clinical outcome - an open label, single arm phase IV pilot study
Sponsor: Medical University Of Vienna (Educational Institution). Phase: Therapeutic use (Phase IV). Countries: Austria (ongoing, recruiting).
Therapeutic area(s): Diseases [C] - Skin and Connective Tissue Diseases [C17]
Gender: Female, Male. Age: 18-64 years, 65+ years. Enrolment: 10.
Status: Ongoing, recruiting. Start date (EU): 2026-02-12. Decision date: 2026-02-07. Results received: No. Last updated: 2026-02-07.

Condition(s): cutaneous lupus erythematosus
Product: Saphnelo 300 mg concentrate for solution for infusion

Primary endpoint: changes in inflammatory cell composition and gene expression profiles in skin and blood samples.
Endpoint(s): the impact of anifriolumab therapy on the clinical course of patients with cutaneous lupus erythematosus.

Source: https://euclinicaltrials.eu/ctis-public/view/2025-523133-26-00